EU clinical trial 2023-508993-27-00: Multicenter, Open-Label, Single Arm, Phase II Exploratory Study to Evaluate the Reinduction and second stop of TKI with Ponatinib in CML in Molecular Response (ResToP)
Protocol code: FCR173011/ResToP
Sponsor: Fundacion Cris De Investigacion Para Vencer El Cancer (Laboratory/Research/Testing facility). Phase: Therapeutic exploratory (Phase II). Countries: Spain (ended).
Therapeutic area(s): Diseases [C] - Neoplasms [C04]
Gender: Female, Male. Age: 18-64 years, 65+ years. Enrolment: 80.
Status: Ended. Start date (EU): 2020-01-17. End date (EU): 2026-01-12. Decision date: 2023-12-21. Results received: No. Last updated: 2025-08-18.

Condition(s): Chronic myelogenous leukemia
Product: Iclusig 15 mg film-coated tablets

Primary endpoint: Proportion of patients with a maintained MMR within 52 weeks following ponatinib TFR.
Endpoint(s): - Incidence of treatment-emergent adverse events (new or worsening from baseline)., - Incidence of thromboembolic and hemorrhagic events, hematologic events and gastrointestinal events., - Proportion of patients still in MR4 within 52 weeks following ponatinib TFR., - Proportion of patients who still have a MMR within 24 weeks following ponatinib TFR., - Progression free survival (PFS), - Treatment-free survival (TFS)

Source: https://euclinicaltrials.eu/ctis-public/view/2023-508993-27-00